EU clinical trial 2024-515019-22-00: A multicenter, prospective, randomized, placebo-controlled, double-blind, multi-arm, multi-stage clinical trial of Ivabradine for heart Rate control In Septic shock [IRISS]
Protocol code: P160925J
Sponsor: Assistance Publique Hopitaux De Paris (Hospital/Clinic/Other health care facility). Phase: Therapeutic confirmatory (Phase III). Countries: France (ended).
Therapeutic area(s): Diseases [C] - Virus Diseases [C02]; Diseases [C] - Bacterial Infections and Mycoses [C01]; Analytical, Diagnostic and Therapeutic Techniques and Equipment [E] - Therapeutics [E02]
Gender: Female, Male. Age: 18-64 years, 65+ years. Enrolment: 429.
Status: Ended. Start date (EU): 2021-02-26. End date (EU): 2026-04-14. Decision date: 2024-12-02. Results received: No. Last updated: 2026-01-07.

Condition(s): Septic shock
Product: Placebo of Procoralan 5 mg, Procoralan 5 mg film-coated tablets

Primary endpoint: There are 2 primary endpoints: i) for treatment selection at interim analysis: the percentage of patients with heart rate within the predefined threshold (80-94 bpm) at hour-48; in case of similar percentages, the percentage of time elapsed within the threshold between inclusion and hour-48 will be considered ii) for the final analysis: 28-day mortality.
Endpoint(s): Determine the tolerance of ivabradine, Evaluate the impact of ivabradine-driven heart rate control on systemic hemodynamics, myocardial stress, organ dysfunction, morbidity, and intensive care mortality, Determine the pharmacokinetics of ivabradine

Source: https://euclinicaltrials.eu/ctis-public/view/2024-515019-22-00